EU clinical trial 2024-516607-16-00: Phase 2a non-commercial and non-randomized intervention study evaluating the efficacy of crizotinib in the treatment of children with severe type 2 neurofibromatosis, in particular those excluded from surgery and / or radiotherapy
Protocol code: KRONF2
Sponsor: Medical University Of Warsaw (Educational Institution). Phase: Therapeutic exploratory (Phase II). Countries: Poland (ongoing, recruiting).
Therapeutic area(s): Diseases [C] - Neoplasms [C04]
Gender: Female, Male. Age: 0-17 years. Enrolment: 1.
Status: Ongoing, recruiting. Start date (EU): 2024-01-17. Decision date: 2024-08-26. Results received: No. Last updated: 2025-05-12.

Condition(s): Neurofibromatosis type 2 is a genetically determined primary malignancy resulting from a mutation that disables the function of the cell division control gene and leads to neoplasia such as benign peripheral nervous system tumors and various benign or locally malignant tumors of the central nervous system. Many complications occur in children more often than in adults and significantly shorten the survival period of affected children.
Product: XALKORI 200 mg hard capsules, XALKORI 250 mg hard capsules

Primary endpoint: Stabilization or (desirable) regression of the primary tumor
Endpoint(s): Stabilization or (desirable) regression of the patient's primary tumor and other tumors for at least 6 months after the end of treatment

Source: https://euclinicaltrials.eu/ctis-public/view/2024-516607-16-00